EU clinical trial 2024-515925-27-00: Effectiveness of a preventive strategy for cytomegalovirus infection guided differently from a universal prophylactic strategy in kidney transplant patients - CYTOPREV
Protocol code: 2020/0422/HP
Sponsor: Centre Hospitalier Universitaire Rouen (Hospital/Clinic/Other health care facility). Phase: Therapeutic confirmatory (Phase III). Countries: France (ongoing, recruiting).
Therapeutic area(s): Analytical, Diagnostic and Therapeutic Techniques and Equipment [E] - Therapeutics [E02]; Diseases [C] - Virus Diseases [C02]
Gender: Female, Male. Age: 18-64 years, 65+ years. Enrolment: 144.
Status: Ongoing, recruiting. Start date (EU): 2024-08-14. Decision date: 2024-08-13. Results received: No. Last updated: 2026-03-26.

Condition(s): CMV
Product: VALGANCICLOVIR VIATRIS 450 mg, comprimé pelliculé

Primary endpoint: Proportion of patients with CMV infection within 6 months of transplantation.
Endpoint(s): Proportion of patients requiring the use of curative antiviral treatment within 6 months after transplantation, Proportion of patients with CMV disease within 6 months of transplantation, Proportion of patients with CMV infection (CMV DNAemia ≥ 305 IU/mL (= 2.3 log IU/mL), CMV infection (CMV DNAemia ≥ 4 log IU/mL requiring curative treatment or CMV disease within the first year following transplant, Number of CMV-specific T lymphocytes (IE-1 and pp65) at W+15, Number of CMV-specific T lymphocytes (IE-1 and pp65) at W+28, CMV serological status of the donor (D+/R+ versus D-/R+), Incremental cost-effectiveness ratio will be calculated for the period from randomization to the visit at S+28 post-transplantation for the experimental group (Arm ) compared to the comparator group (Arm ) with the average costs and efficacies for each strategy. The incremental cost-effectiveness ratio will be presented as additional cost per CMV infection avoided.

Source: https://euclinicaltrials.eu/ctis-public/view/2024-515925-27-00